EU clinical trial 2023-510147-37-00: A Multicentre, Open-Label, Randomized, Phase IV Study to Investigate Acalabrutinib Monotherapy Compared to Investigator’s Choice of Treatment in Adults (> 18 Years) with Chronic Lymphocytic Leukemia and Moderate to Severe Cardiac Impairment
Protocol code: D8223C00016
Sponsor: AstraZeneca AB (Pharmaceutical company). Phase: Therapeutic use (Phase IV). Countries: Spain (ongoing, recruiting), Italy (ongoing, recruiting), Poland (ongoing, recruiting), Czechia (authorised, recruiting).
Therapeutic area(s): Diseases [C] - Hemic and Lymphatic Diseases [C15]
Gender: Female, Male. Age: 18-64 years, 65+ years. Enrolment: 33.
Start date (EU): 2024-12-18. Decision date: 2024-07-22. Results received: No. Last updated: 2026-07-20.
Decision dates by country: PL: 2024-09-26, IT: 2024-07-23, CZ: 2024-11-28, ES: 2024-07-22

Condition(s): Chronic Lymphocytic Leukaemia and Moderate to Severe Cardiac Impairment
Product: Calquence 100 mg film-coated tablets, Calquence 100 mg film-coated tablets

Primary endpoint: Frequency and time to discontinuation of any study treatment due to worsening in cardiovascular. function or cardiovascular Adverse events (AEs)., Incidence of Grade 4 and 5 cardiovascular events of interest., Incidence and relationship to study treatment of: - Grade ≥ 3 AEs. - Serious adverse events (SAEs). - Non-cardiovascular AE that lead to discontinuation of any study treatment. - Events of clinical interest (ECI)as defined in the Statistical Analysis Plan (SAP).
Endpoint(s): Overall survival (OS), defined as the time from randomisation to death from any cause., Per iwCLL 2018 criteria (Hallek et al, 2018): Event-free survival (EFS), defined as the time from randomisation to disease progression, initiation of subsequent anti-CLL therapy, or death from any cause, whichever occurs first., Overall response rate (ORR), defined as the proportion of patients with a complete response (CR), complete response with incomplete bone marrow recovery (CRi), nodular partial response (nPR) or partial response (PR)., Duration of response (DOR), defined as the time from the first documented response (PR or better) to disease progression or death (by any cause in the absence of disease progression)., Progression‑free survival (PFS), defined as the time from randomisation to disease progression or death (by any cause in the absence of disease progression).

Source: https://euclinicaltrials.eu/ctis-public/view/2023-510147-37-00